EU clinical trial 2025-521108-23-00: A multicenter, randomized, double-blind, parallel group, placebo-controlled study of the efficacy and safety of early depemokimab initiation as add-on treatment in COPD patients with type 2 inflammation.
Protocol code: 224295
Sponsor: Glaxosmithkline Research & Development Limited (Pharmaceutical company). Phase: Therapeutic confirmatory (Phase III). Countries: Germany (ongoing, recruiting), Belgium (authorised, recruitment pending), Netherlands (authorised, recruitment pending), Denmark (authorised, recruitment pending), Spain (ongoing, recruiting), Greece (ongoing, recruiting), Poland (ongoing, recruiting), Hungary (authorised, recruitment pending), France (authorised, recruitment pending), Italy (authorised, recruitment pending), Bulgaria (ongoing, recruiting), Romania (ongoing, recruiting).
Therapeutic area(s): Diseases [C] - Respiratory Tract Diseases [C08]
Gender: Female, Male. Age: 18-64 years, 65+ years. Enrolment: 549.
Start date (EU): 2026-05-19. Decision date: 2026-04-07. Results received: No. Last updated: 2026-08-02.
Decision dates by country: DE: 2026-04-10, BE: 2026-04-07, FR: 2026-04-08, DK: 2026-04-07, NL: 2026-04-08, RO: 2026-04-14, GR: 2026-04-08, BG: 2026-04-09, PL: 2026-04-09, HU: 2026-04-13, IT: 2026-04-13, ES: 2026-04-09

Condition(s): Chronic Obstructive Pulmonary Disease
Product: Novolizer Salbutamol 100 microgrammes/dose, poudre pour inhalation, Sterile 0.9% (w/v) sodium chloride solution in single-use PFS

Primary endpoint: Annualized rate of moderate/severe exacerbations.
Endpoint(s): Time to first moderate/severe exacerbation., Change from baseline in SGRQ total score (measured using the SGRQ-C) at Week 52., Change from baseline in E-RS: COPD total score at Week 52.

Source: https://euclinicaltrials.eu/ctis-public/view/2025-521108-23-00